EU clinical trial 2022-502638-17-00: A phase I, randomized, double-blind, placebo-controlled, two-way cross-over, multiple dose study to evaluate the pharmacodynamic effects of TRV045 on the cortical excitability in healthy male adults
Protocol code: CP045-1004
Sponsor: Trevena Inc. (Pharmaceutical company). Phase: Human Pharmacology (Phase I)- Other. Countries: Netherlands (ended).
Therapeutic area(s): Diseases [C] - Nervous System Diseases [C10]
Gender: Male. Age: 18-64 years. Enrolment: 24.
Status: Ended. Start date (EU): 2023-02-03. End date (EU): 2023-06-09. Decision date: 2023-01-31. Results received: Yes. Last updated: 2023-04-17.

Condition(s): Epilepsy
Product: Trv045 placebo

Primary endpoint: Change from baseline in Motor Evoked Potential: • Peak-to-peak amplitude (μV)

Source: https://euclinicaltrials.eu/ctis-public/view/2022-502638-17-00